EU clinical trial 2024-514992-16-00: Phase 1/2 trial evaluating isatuximab in combination with SAR445761 (belumosudil) and dexamethasone in relapsed or refractory multiple myeloma (RRMM)
Protocol code: ACT16482-05
Sponsor: Sanofi-Aventis Recherche & Developpement (Pharmaceutical company). Phase: Phase I and Phase II (Integrated)- Other. Countries: Norway (ongoing, recruiting), France (ongoing, recruiting), Italy (ongoing, recruiting), Germany (ongoing, recruiting), Portugal (ended), Greece (ongoing, recruiting).
Therapeutic area(s): Diseases [C] - Neoplasms [C04]
Gender: Female, Male. Age: 18-64 years, 65+ years. Enrolment: 17.
Start date (EU): 2021-03-31. Decision date: 2024-10-11. Results received: No. Last updated: 2026-05-04.
Decision dates by country: FR: 2024-10-17, PT: 2024-10-14, NO: 2024-10-16, IT: 2024-10-16, GR: 2024-10-11, DE: 2024-10-11

Condition(s): Cancer
Product: Dexamethason 8 mg JENAPHARM®, SAR445761 - belumosudil, Isatuximab, Isatuximab, Dexamethason 4 mg JENAPHARM®

Primary endpoint: Part 1 (dose finding, experimental substudies): Determination of recommended dose of novel agents in combination with isatuximab, Part 2 (expansion, independent experimental substudies):Overall Response Rate (ORR) in independent experimental substudies
Endpoint(s): Part 1 (dose finding, experimental substudies): ORR, Part 1 (dose finding, experimental substudies): VGPR or better, Part 2 (expansion, independent experimental substudies): VGPR or better, Clinical Benefit Rate (CBR) in each treatment arm, Duration of Response (DOR) in each treatment arm, Time to First Response (TT1R) in each treatment arm, Time to Best Response (TTBR) in each treatment arm, Number of participants with treatment emergent adverse events and serious adverse events in each treatment arm, Progression-free survival (PFS) in each treatment arm, Overall Survival (OS) in each treatment arm, Immunogenicity of isatuximab and novel agents, Concentration of novel agents (experimental arms) and isatuximab (Ctrough), Disease-specific HRQL will be assessed using the European Organization for Research and Treatment of Cancer (EORTC) core quality of life questionnaire (QLQ-C30), Disease- and treatment-related quality of life will be assessed using the EORTC multiple myeloma module (QLQ-MY20) questionnaire, Global impact of side effects will be assessed using the Functional Assessment of Cancer Therapy (FACT-G) (GP5), Estimate/Confirm established clinically meaningful change scores for clinical outcome assessments (COAs)/domain scores using the Patient Global Impression of Severity (PGIS) and Patient Global Impression of Change (PGIC) scales, Maximum concentration observed after the first infusion (Cmax) for Belumosudil - Substudy 05, Time to reach Cmax (tmax) for Belumosudil - Substudy 05, Area under the concentration versus time curve calculated using the trapezoidal method from 0 to 8h (AUC0-8h) for Belumosudil - Substudy 05

Source: https://euclinicaltrials.eu/ctis-public/view/2024-514992-16-00